EU clinical trial 2024-510834-42-00: Efficacy comparison of two doses of vitamin D3 in critically ill patients undergoing continuous renal replacement therapy - NephroD
Protocol code: NephroD_2021
Sponsor: Uniwersytecki Szpital Kliniczny W Opolu (Hospital/Clinic/Other health care facility). Phase: Therapeutic use (Phase IV). Countries: Poland (ongoing, recruiting).
Therapeutic area(s): Analytical, Diagnostic and Therapeutic Techniques and Equipment [E] - Therapeutics [E02]
Gender: Female, Male. Age: 18-64 years, 65+ years. Enrolment: 138.
Status: Ongoing, recruiting. Start date (EU): 2022-12-19. Decision date: 2024-08-09. Results received: No. Last updated: 2026-08-05.

Condition(s): Vitamin D3 deficiency
Product: Devikap, 15 000 IU/ml, krople doustne, roztwór

Primary endpoint: Percentage of patients with 25(OH)D3 serum levels ≥30 ng/mL on days 3 and 7 after vitamin D3 administration.
Endpoint(s): Number of patients who died on day 28 and 90 after administration of vitamin D3 preparation., Duration of treatment in the ICU of patients receiving vitamin D3 preparation., SOFA score on day 3 and 7 in patients receiving vitamin D3 preparation., Duration of catecholamine supply in patients receiving vitamin D3., The CRRT duration in hours from the IMP administration until the visit 4 start., Total gastric residual volume in milliliters from the IMP administration until the visit 3 start., Safety Assessment Endpoint: Percentage of patients who achieved toxic serum vitamin D3 concentrations (25(OH)D3 ≥150 ng/mL) on Days 3 and 7., Safety Assessment Endpoint: Percentage of patients who achieved a serum total calcium concentration (>11 mg/dL) on Days 3 and 7.

Source: https://euclinicaltrials.eu/ctis-public/view/2024-510834-42-00